EU clinical trial 2024-512294-26-00: A phase I, multicentre, open-label, dose escalation study to determine the safety and preliminary efficacy of MBS8(1V270) administered intravenously to cancer patients with advanced solid tumours
Protocol code: MBS8-101
Sponsor: MonTa Biosciences ApS (Pharmaceutical company). Phase: Human Pharmacology (Phase I)- First administration to humans. Countries: Belgium (ended), Spain (ongoing, recruiting), Denmark (ongoing, recruiting).
Therapeutic area(s): Diseases [C] - Neoplasms [C04]
Gender: Female, Male. Age: 18-64 years, 65+ years. Enrolment: 103.
Start date (EU): 2024-04-10. Decision date: 2024-04-09. Results received: No. Last updated: 2026-06-01.
Decision dates by country: BE: 2024-04-22, ES: 2024-04-11, DK: 2024-04-09

Condition(s): Advanced solid tumors

Source: https://euclinicaltrials.eu/ctis-public/view/2024-512294-26-00